EU clinical trial 2023-508022-10-00: I4V-MC-JAJA (RA-BRIDGE): A Randomized, Active-Controlled, Parallel-Group, Phase 3b/4 Study of Baricitinib in Patients with Rheumatoid Arthritis
Protocol code: I4V-MC-JAJA
Sponsor: Eli Lilly & Co. (Pharmaceutical company). Phase: Therapeutic use (Phase IV). Countries: Hungary (ended), Slovakia (ended), Lithuania (ended), Austria (ended), France (ended), Greece (ended), Spain (ended), Italy (ended), Poland (ended), Denmark (ended), Netherlands (ended), Germany (ended), Belgium (ended), Czechia (ended), Romania (ended).
Therapeutic area(s): Diseases [C] - Immune System Diseases [C20]
Gender: Female, Male. Age: 18-64 years, 65+ years. Enrolment: 1419.
Status: Ended. Start date (EU): 2019-07-25. End date (EU): 2025-04-10. End date: 2025-05-29. Decision date: 2024-01-17. Results received: Yes. Last updated: 2026-06-22.
Decision dates by country: LT: 2024-01-30, GR: 2024-03-04, DE: 2024-01-23, SK: 2024-01-18, IT: 2024-01-22, AT: 2024-02-27, HU: 2024-01-23, FR: 2024-01-18, CZ: 2024-01-18, DK: 2024-01-17, PL: 2024-02-29, BE: 2024-01-25, ES: 2024-01-18, RO: 2024-01-22, NL: 2024-01-22

Condition(s): Rheumatoid Arthritis
Product: ETANERCEPT, ADALIMUMAB, BARICITINIB, ADALIMUMAB, BARICITINIB

Primary endpoint: Time from First Dose of Study Treatment to First Event of Venous Thromboembolism (VTE) [ Time Frame: Baseline through Study Completion (Approximately 5.5 Years) ]

Source: https://euclinicaltrials.eu/ctis-public/view/2023-508022-10-00